EU clinical trial 2022-502661-23-00: A phase I/II, multicenter study evaluating the feasibility, safety, and efficacy of point-of-care manufactured GLPG5101 (19CP02) in subjects with relapsed/refractory B-cell non-Hodgkin lymphoma
Protocol code: CP0201-NHL
Sponsor: Lakefront Biotherapeutics (Pharmaceutical company). Phase: Phase I and Phase II (Integrated)- First administration to humans. Countries: Netherlands (ended), Belgium (ended), Finland (ended).
Therapeutic area(s): Diseases [C] - Neoplasms [C04]
Gender: Female, Male. Age: 18-64 years, 65+ years. Enrolment: 160.
Status: Ended. Start date (EU): 2024-06-11. End date (EU): 2026-05-04. End date: 2026-05-28. Decision date: 2022-12-16. Results received: No. Last updated: 2026-06-02.
Decision dates by country: BE: 2023-02-02, FI: 2024-10-18, NL: 2022-12-16

Condition(s): Relapsed/refractory B-cell non-Hodgkin lymphoma
Product: 19CP02

Primary endpoint: Phase I: Incidence of (S)AEs, Dose-limiting toxicities (DLTs) until Day 28, Phase II: Objective response (OR) until 2 years post GLPG5101 infusion per Lugano Classification or IPCG criteria for PCNSL
Endpoint(s): 1. Type, frequency and severity of (S)AEs (including AEs of special interest) and laboratory abnormalities, 2. OR until 2 years post GLPG5101 infusion per the Lugano classification (for Phase I and Cohort 6b only), 3. OR until 2 years post GLPG5101 infusion per iwCLL criteria (Richter Transformation of DLBCL subtype [DLBCL-RT, Cohort 7] only), 4. Complete response (CR) until 2 years post infusion per Lugano Classification, or IPCG criteria for PCNSL, 5. Duration of response (DOR), 6. Duration of complete response (DOCR), 7. Progression-free survival (PFS), 8. Overall survival (OS), 9. Minimal Residual Disease (MRD) negativity rate at CR (DLBCL, MCL, and DLBCL-RT), 10. Levels of anti-CD19 CAR T cells in blood at peak and over time, 11. Levels of chemokines and cytokines in serum over time, 12. Proportion of successfully manufactured products within the predefined release specifications, 13. Change from baseline in measurement of HRQoL as assessed using the European Organization for Research and Treatment of Cancer (EORTC) QLQ-C30 and its CLL-specific module QLQCLL-17 (DLBCL-RT only), and EuroQol EQ-5D-5L

Source: https://euclinicaltrials.eu/ctis-public/view/2022-502661-23-00